EU clinical trial 2023-508658-24-00: EORTC-1525-LCG: Single-arm, multicenter, phase II study of immunotherapy in patients with type B3 thymoma and thymic carcinoma previously treated with chemotherapy - (Nivothym)
Protocol code: 1525-LCG
Sponsor: European Organisation For Research And Treatment Of Cancer (Patient organisation/association). Phase: Therapeutic exploratory (Phase II). Countries: Belgium (authorised, recruitment pending), Spain (authorised, recruitment pending), Netherlands (authorised, recruitment pending), France (authorised, recruitment pending).
Therapeutic area(s): Diseases [C] - Neoplasms [C04]
Gender: Female, Male. Age: 18-64 years, 65+ years. Enrolment: 99.
Status: Authorised, recruitment pending. Decision date: 2024-08-20. Results received: No. Last updated: 2026-07-31.
Decision dates by country: BE: 2024-08-20, FR: 2024-08-22, ES: 2024-08-21, NL: 2024-08-21

Condition(s): type B3 thymoma and thymic carcinoma
Product: IPILIMUMAB, NIVOLUMAB

Primary endpoint: Progression Free Survival Rate at 6 months (PFSR-6) per independent radiological review
Endpoint(s): Progression Free Survival Rate at 6 months (PFSR-6) according to RECIST 1.1 per local investigator assessment, Safety according to CTCAE v4.0, Overall Response Rate (ORR) according to RECIST 1.1 per local investigator assessment, Disease Control Rate according to RECIST 1.1 per local investigator assessment (DCR), Duration of response according to RECIST 1.1 per local investigator assessment, Progression Free Survival (PFS) according to RECIST 1.1 per local investigator assessment, Overall Survival (OS), Progression Free Survival for patients continuing treatment after progression

Source: https://euclinicaltrials.eu/ctis-public/view/2023-508658-24-00